EU clinical trial 2025-523465-21-00: Rituximab as therapy for autoantibody mediated fibromyalgia (RAFT) - proof of concept
Sponsor: Region Stockholm – SLSO (Hospital/Clinic/Other health care facility). Phase: Therapeutic confirmatory (Phase III). Countries: Sweden (authorised, recruitment pending).
Therapeutic area(s): Diseases [C] - Musculoskeletal Diseases [C05]
Gender: Female, Male. Age: 18-64 years. Enrolment: 15.
Status: Authorised, recruitment pending. Decision date: 2026-02-12. Results received: No. Last updated: 2026-02-12.

Condition(s): Fibromyalgia
Product: Paracetamol ABECE 500 mg filmdragerade tabletter, Medrol 16 mg tabletter, Cetirizin ABECE 10 mg filmdragerade tabletter, RITUXIMAB

Primary endpoint: The primary outcome measure is mean reduction of pain in VAS (mm) 16 weeks after rituximab treatment.
Endpoint(s): Secondary outcome measures are improvement in patient perceived FM symptoms measured by Fibromyalgia Impact Questionnaire (FIQ) and Patient Global Impression of Change (PGIC) and objective reduction of % of satellite glia cell binding human IgG, which are regarded to mediate pain at week 16.

Source: https://euclinicaltrials.eu/ctis-public/view/2025-523465-21-00